EU clinical trial 2025-522669-32-00: A Phase 3, Open-Label, Randomized, Multicenter Study to Evaluate Anti-tumor Efficacy of DZD8586 versus Investigator's Choice in Patients with Relapsed/Refractory Chronic Lymphocytic Leukemia/Small Lymphocytic Lymphoma
Protocol code: DZ2024B0002
Sponsor: Dizal Pharmaceutical Co. Ltd. (Pharmaceutical company). Phase: Therapeutic confirmatory (Phase III). Countries: Italy (authorised, recruiting), Poland (ongoing, recruiting).
Therapeutic area(s): Diseases [C] - Hemic and Lymphatic Diseases [C15]; Diseases [C] - Neoplasms [C04]
Gender: Female, Male. Age: 18-64 years, 65+ years. Enrolment: 55.
Start date (EU): 2025-12-18. Decision date: 2025-11-03. Results received: No. Last updated: 2026-06-12.
Decision dates by country: IT: 2025-11-03, PL: 2025-11-13

Condition(s): Relapsed/Refractory Chronic Lymphocytic Leukemia/Small Lymphocytic Lymphoma
Product: Zydelig 150 mg film-coated tablets, Truxima 500 mg concentrate for solution for infusion, Bendamustin Hikma 2,5 mg/ml Pulver für ein Konzentrat zur Herstellung einer Infusionslösung, Zydelig 100 mg film-coated tablets, Zydelig 100 mg film-coated tablets, Zydelig 100 mg film-coated tablets, Birelentinib, Zydelig 150 mg film-coated tablets, Truxima 500 mg concentrate for solution for infusion, Bendamustin Hikma 2,5 mg/ml Pulver für ein Konzentrat zur Herstellung einer Infusionslösung, Zydelig 100 mg film-coated tablets, Truxima 500 mg concentrate for solution for infusion, Bendamustin Hikma 2,5 mg/ml Pulver für ein Konzentrat zur Herstellung einer Infusionslösung, Zydelig 150 mg film-coated tablets, Bendamustin Hikma 2,5 mg/ml Pulver für ein Konzentrat zur Herstellung einer Infusionslösung, Zydelig 150 mg film-coated tablets, Truxima 500 mg concentrate for solution for infusion

Primary endpoint: • Progression free survival (PFS) assessed by Independent Review Committee (IRC) per iwCLL 2018/Lugano 2014
Endpoint(s): • PFS assessed by investigator • Objective response rate (ORR) and duration of response (DoR) assessed by IRC and investigator • Overall survival (OS) • Time to next treatment (TTNT) • EuroQol Group 5-level EQ-5D Questionnaire (EQ5D-5L) and European Organization for Research and Treatment of Cancer Quality of Life Questionnaire (EORTC QLQ-C30), • Safety profiles, for example, adverse events (AEs), serious adverse events (SAEs), ≥ Grade 3 AEs, etc., per Common Terminology Criteria in Adverse Events v5.0 (CTCAE v5.0), • Plasma concentration of DZD8586 and DZ4581, and derived corresponding PK parameters

Source: https://euclinicaltrials.eu/ctis-public/view/2025-522669-32-00